EU clinical trial 2024-520399-84-00: "Comparison between norepinephrine and dobutamine in patients with cardiogenic shock"
Sponsor: Azienda Unita' Sanitaria Locale Toscana Sud Est (Hospital/Clinic/Other health care facility). Phase: Therapeutic use (Phase IV). Countries: Italy (ongoing, recruitment ended).
Therapeutic area(s): Diseases [C] - Cardiovascular Diseases [C14]
Gender: Female, Male. Age: 18-64 years, 65+ years. Enrolment: 46.
Status: Ongoing, recruitment ended. Start date (EU): 2025-02-03. Decision date: 2025-02-03. Results received: No. Last updated: 2025-08-11.

Condition(s): Cardiogenic shock
Product: NORADRENALINE TARTRATE, DOBUTAMINE

Primary endpoint: - Change in blood lactate concentration measured as the difference between the maximum value at baseline: 0-1 hours after randomization and 72 hours after randomization, in the two treatment arms. - In case of death: change in blood lactate concentration measured as the difference between the maximum value at baseline: 0-1h after randomization and the last available lactate value from randomization, in the two treatment arms.
Endpoint(s): - death or need for ECMO/LVAD at 72 hours - death or need for ECMO/LVAD at discharge - change in SOFA score between baseline (0-1 hour from randomization) and 72 hours from randomization and between baseline (0-1 hour from randomization) and 7 days from randomization - lactate AUC (0-72 hours) - need for additional extra-trial inotrope at 72 hours

Source: https://euclinicaltrials.eu/ctis-public/view/2024-520399-84-00